EU clinical trial 2025-522587-33-00: A Randomized, Double-blind, Placebo-controlled Trial to Evaluate the Safety, Tolerability, and Efficacy of TAK-360 for the Treatment of Narcolepsy with Cataplexy (Narcolepsy Type 1)
Protocol code: TAK-360-2004
Sponsor: Takeda Development Center Americas Inc. (Pharmaceutical company). Phase: Therapeutic exploratory (Phase II). Countries: Spain (authorised, recruitment pending), Italy (authorised, recruitment pending), France (authorised, recruitment pending).
Therapeutic area(s): Diseases [C] - Nervous System Diseases [C10]
Gender: Female, Male. Age: 18-64 years, 65+ years. Enrolment: 69.
Status: Authorised, recruitment pending. Decision date: 2026-06-22. Results received: No. Last updated: 2026-07-16.
Decision dates by country: FR: 2026-07-16, IT: 2026-07-16, ES: 2026-06-22

Condition(s): Narcolepsy with Cataplexy (NT1)

Primary endpoint: Occurrence of at least 1 TEAE during the trial.
Endpoint(s): 1. Parts A and B: Change from baseline in mean sleep latency from the MWT at Week 6., 2. Parts A and B: Change from baseline in ESS total score at Week 6., 3. Parts A and B: WCR at Week 6.

Source: https://euclinicaltrials.eu/ctis-public/view/2025-522587-33-00